EU clinical trial 2022-500570-33-00: A Randomised, Open Label, Phase III, Multicenter, 2-arm study comparing 177Lu-PSMA-I&T versus Apalutamide/Enzalutamide/Abiraterone, in metastatic Hormon Sensitive Prostate Cancer Patients receiving castration treatment
Protocol code: Lut-AEA
Sponsor: Region Västerbotten, Umea University (Hospital/Clinic/Other health care facility, Educational Institution). Phase: Therapeutic confirmatory (Phase III). Countries: Sweden (ongoing, recruiting).
Therapeutic area(s): Diseases [C] - Male Urogenital Diseases [C12]
Gender: Male. Age: 18-64 years, 65+ years. Enrolment: 844.
Status: Ongoing, recruiting. Start date (EU): 2024-02-28. Decision date: 2023-05-03. Results received: No. Last updated: 2024-12-02.

Condition(s): Prostate cancer
Product: Xtandi - 40 mg film-coated tablets, ABIRATERONE ACETATE, Erleada 60 mg film-coated tablets, DEXAMETHASONE, METOCLOPRAMIDE HYDROCHLORIDE, ONDANSETRON, BETAMETHASONE, [177Lu]PSMA-I&T

Primary endpoint: To evaluate progression free survival between the two treatment arms (radiographic, clinical, or prostate-specific antigen [PSA] progression-free survival). That is, time from start of treatment until signs of progressive disease. Where progression is defined according to Prostate Cancer Working Group 3(PCWG3) and RECIST v 1.1.
Endpoint(s): To evaluate and compare between the two treatment arms, time from start of treatment to death (disease specific and overall survival), To evaluate and compare between the two treatment arms, Objective response rate: Radiological and PSA response rate is evaluated at week 14 from start with study drugs according to PCWG3 and RECIST 1.1, To evaluate and compare between the two treatment arms, time to first symptomatic skeletal event (SSE), To evaluate and compare between the two treatment arms, Safety Quality of Life will be assested using FACT-P-T and BPI-SF, Evaluate toxic effect of dose on normal tissue and tumor in the experimental arm.

Source: https://euclinicaltrials.eu/ctis-public/view/2022-500570-33-00